EU clinical trial 2024-514306-31-00: A multi-centre, randomised, placebo-controlled, double-blind, parallel-group trial to evaluate safety and efficacy of spesolimab (BI 655130) in adult patients with ulcerative pyoderma gangrenosum (PG) who require systemic therapy
Protocol code: 1368-0140
Sponsor: Leo Pharma A/S (Pharmaceutical company). Phase: Therapeutic confirmatory (Phase III). Countries: Germany (ongoing, recruiting), Poland (ongoing, recruiting), Norway (ongoing, recruiting), Austria (ongoing, recruiting), Belgium (ongoing, recruiting), Sweden (ongoing, recruiting), Spain (ongoing, recruiting), Italy (ongoing, recruiting), Finland (authorised, recruiting), France (ongoing, recruiting), Portugal (ongoing, recruiting).
Therapeutic area(s): Diseases [C] - Skin and Connective Tissue Diseases [C17]
Gender: Female, Male. Age: 18-64 years, 65+ years. Enrolment: 30.
Start date (EU): 2025-02-13. Decision date: 2024-12-18. Results received: No. Last updated: 2026-08-03.
Decision dates by country: AT: 2024-12-27, PL: 2024-12-20, BE: 2024-12-19, FR: 2024-12-18, SE: 2024-12-20, DE: 2024-12-20, FI: 2024-12-18, ES: 2024-12-18, PT: 2024-12-18, IT: 2024-12-19, NO: 2024-12-18

Condition(s): Pyoderma gangrenosum
Product: Placebo matching to spesolimab

Primary endpoint: Achievement of complete closure (PGAR-100 (100% pyoderma gangrenosum area reduction)) of the target PG ulcer at any time up to Week 26 and confirmed at the next consecutive visit (at least 2 weeks later)
Endpoint(s): Key secondary endpoint: Achievement of PGAR-100 of the target PG ulcer at Week 26 confirmed at the next consecutive visit (at least 2 weeks later), Achievement of 50% area reduction (PGAR-50) of the target PG ulcer at any time up to Week 26, Achievement of ≥ 3 point reduction in NRS Pain score from baseline at Week 26, Achievement of a DLQI of ≤ 5 at Week 26, Achievement of PGAR-100 of any measurable PG ulcer (≥5 cm2 at baseline) at any time up to Week 26 and confirmed at the next consecutive visit (at least 2 weeks later), Achievement of PGAR-100 of all measurable PG ulcers (≥5 cm2 at baseline) at any time up to Week 26 and confirmed at the next consecutive visit (at least 2 weeks later), Time to recurrence among trial participants who had achieved CR at Week 26 up to Week 52. Recurrence is defined as emergence of the disease (PG ulcer[s]) at the previous ulcer sites(s) or emergence of any new PG ulcer(s), 5. Achievement of complete response (CR, defined as all ulcers completely closed and reepithelised without drainage and requirements for dressing, as assessed by the investigator) at Week 26

Source: https://euclinicaltrials.eu/ctis-public/view/2024-514306-31-00